EU clinical trial 2025-524374-42-00: Immunogenicity and safety of two respiratory syncytial virus vaccine strategies in lung and allogeneic haematopoietic stem cell transplant recipients: A phase 2 trial RSVaxID
Protocol code: 69HCL25_0854
Sponsor: Hospices Civils De Lyon (Hospital/Clinic/Other health care facility). Phase: Therapeutic exploratory (Phase II). Countries: France (authorised, recruitment pending).
Therapeutic area(s): Analytical,Diagnostic,Therapeutic Techniques and Equipment [E]-Surgical Procedures, Operative [E04]
Gender: Female, Male. Age: 18-64 years, 65+ years. Enrolment: 400.
Status: Authorised, recruitment pending. Decision date: 2026-07-06. Results received: No. Last updated: 2026-07-06.

Condition(s): allogeneic haematopoietic stem cell transplant recipient, lung transplant
Product: Abrysvo powder and solvent for solution for injection Respiratory syncytial virus vaccine (bivalent, recombinant), Arexvy powder and suspension for suspension for injection Respiratory Syncytial Virus (RSV) vaccine (recombinant, adjuvanted)

Primary endpoint: Proportion of participants in each group who achieve a seroresponse one month after completion of vaccination (V2). A seroresponse is defined as either (1) seroconversion or (2) a ≥4-fold rise in RSVpreF-binding serum IgG concentration from baseline, as measured by enzyme immunoassay (EIA).
Endpoint(s): RSV-A and RSV-B serum 50% neutralizing geometric mean titres (GMT) and corresponding neutralizing titre geometric mean fold rises (GMFR), measured by an RSV neutralization assay [time frame: baseline (visit 1), one month after completing vaccination (V2)]., Geometric mean concentrations (GMC) and corresponding geometric mean fold rises (GMFR) of RSVpreF-binding serum IgG, measured by standard EIA; proportion of participants in each group achieving a ≥2-fold rise in RSVpreF-binding serum IgG between baseline and visit 2, as measured by standard EIA; Log (serum dilution) for 50% signal inhibition in D25- and palivizumab-competitive EIA [time frame: baseline, pre-dose-2 (only arm B, visit 1b), v2 and one-year after first vaccine dose (v3), Descriptive: frequency, type and severity of local and systemic solicited adverse events within 7 days following each vaccine administration; frequency, type and severity of unsolicited adverse events within 30 days following each vaccine administration; severe adverse events and adverse events of special interest until the end of study, Geometric mean titres (GMT) and corresponding geometric mean fold rises (GMFR) of RSVpreF-binding oral fluid IgA, measured by EIA in oral fluid [time frame: baseline, visit 2], Analysis of determinants of humoral immunogenicity: [Time frame: baseline, V1b, V2, V3] age, time from transplantation, acute rejection episode(s) before and during the study period, type of induction immunosuppression, ongoing immunosuppressive treatment at the time of vaccination (in LTR); age, time from transplantation, stem cell source, type of donor, acute/chronic GVHD before and during the study period, ongoing immunosuppressive treatment at the time of vaccination (in HSCTR), Descriptive: frequency and severity (overall survival, need for hospitalization, ICU hospitalization, type of treatment, respiratory deterioration [in LTR only] until the end of study) of RT-PCR confirmed, medically attended RSV infection episodes, Full-length genome sequencing and sequence analysis of any clinical RSV isolate, Geometric mean concentrations (GMC) of RSVpreF-binding serum IgG, geometric mean titres (GMT) of RSV-A/RSV-B serum neutralizing antibodies (NAbs) and GMT of RSVpreF-binding oral fluid IgA in vaccinated participants with medically attended RSV infection [Time frame: at the time of medically attended RSV infection], Geometric mean concentrations (GMC) of RSVpreF-binding serum IgG, geometric mean titres (GMT) of RSV-A/RSV-B serum neutralizing antibodies (NAbs) and GMT of RSVpreF-binding oral fluid IgA in participants with medically attended RSV infection and matched participants without medically attended RSV infection episodes [Time frame: baseline, visit 2]

Source: https://euclinicaltrials.eu/ctis-public/view/2025-524374-42-00